EU clinical trial 2024-520103-38-00: Bioavailability study of stiripentol after single oral administration of two different formulations (capsule and oral suspension) in 24 healthy subjects
Protocol code: STP218
Sponsor: Biocodex (Pharmaceutical company). Phase: Human Pharmacology (Phase I)- Other. Countries: France (ended).
Therapeutic area(s): Diseases [C] - Nervous System Diseases [C10]
Gender: Female, Male. Age: 18-64 years. Enrolment: 24.
Status: Ended. Start date (EU): 2025-05-26. End date (EU): 2025-08-27. Decision date: 2025-04-10. Results received: No. Last updated: 2025-06-11.

Condition(s): Dravet syndrome

Source: https://euclinicaltrials.eu/ctis-public/view/2024-520103-38-00